EU clinical trial 2023-509377-23-00: "SAFE DISCONTINUATION OF ANTIDEPRESSANTS IN INDIVIDUALS WITH CLINICALLY REMITTED DEPRESSIVE DISORDERS"
Protocol code: DISCARD
Sponsor: Universita Degli Studi Di Verona (Educational Institution). Phase: Therapeutic use (Phase IV). Countries: Italy (ongoing, recruiting).
Therapeutic area(s): Psychiatry and Psychology [F] - Mental Disorders [F03]
Gender: Female, Male. Age: 18-64 years, 65+ years. Enrolment: 150.
Status: Ongoing, recruiting. Start date (EU): 2026-02-13. Decision date: 2024-10-08. Results received: No. Last updated: 2026-02-20.

Condition(s): Patients with currently remitted depressive disorders.
Product: Zaredrop 75 mg/ml soluzione orale, Laroxyl 40 mg/ml gocce orali soluzione, FLUOXETINA DOC Generici 20 mg/5 ml Soluzione orale, Zoloft 20 mg/ml concentrato per soluzione orale, Brintellix 20 mg/ml oral drops, solution, Daparox 33,1 mg/ml, gocce orali, soluzione., CITALOPRAM ABC 40 mg/ml gocce orali, soluzione, ESCITALOPRAM DOC 20 mg/ml gocce orali, soluzione

Primary endpoint: Proportion of participants who fail to discontinue the AD or re-start an AD during the 16 weeks after its discontinuation. Failure to discontinue the AD is defined as continued use of the medication beyond the predefined tapering schedule, allowing for a tolerance period of no more than 15% of the total tapering duration. This failure may occur for any reason, such as the onset of withdrawal symptoms or the recurrence of depressive or anxiety symptoms.
Endpoint(s): Proportion of participants who fail to discontinue the AD by the end of the pre-defined schedule (with a tolerance period of no more than 15% of the total duration of the tapering phase), Proportion of participants who re-start an AD for any reason during the 16 weeks after its discontinuation. No pre-defined criteria for re-starting the AD will be employed. As occurs in realworld practice, the decision to re-start the AD can be taken by the recruiting psychiatrist, another practitioner not involved in the study, or independently by the participant;, Proportion of participants failing to adhere to the pre-defined tapering schedule for any reason, including: new medical condition or treatment no longer compatible with the discontinuation strategy; new psychiatric condition or treatment no longer compatible with the discontinuation strategy; the participant discontinues the AD more quickly than the schedule; the participant resumes the previous AD dose and abandon the tapering schedule for reasons other than withdrawal symptoms or relapse., Proportion of participants experiencing “clinically relevant withdrawal symptoms” throughout the discontinuation and the 16-weeks follow-up period, defined as having at least one severe/extremely severe symptom or at least two moderately severe symptoms on the Discontinuation-Emergent Signs and Symptoms Scale (DESS) (Lewis et al., 2021), modified in order to assess the severity of each symptom as follows: 0=not present, 1=minimal, 2=mild, 3=moderate, 4=severe, 5=extremely severe;, Mean of DESS highest overall scores during the tapering phase and the 16-weeks follow-up period;, Proportion of participants experiencing clinical relapse throughout the discontinuation and the 16- weeks follow-up period, defined as having at least moderately severe depression or anxiety symptoms, namely a score ≥15 on the PHQ-9 or ≥10 on the GAD-7 (Kroenke et al., 2016);, Proportion of participants leaving the study early due to any reason without meeting criteria for the primary outcome. This includes people who do not attend follow-up visits and cannot be contacted, people who refuse to be involved in follow-up assessments, or people who die during the tapering or the follow-up for reasons unrelated to withdrawal symptoms or relapse., Exploratory end point: Proportion of participants requiring one or more “rescue strategies” to address withdrawal symptoms during the tapering phase and the 16-weeks follow-up period;, Exploratory end point: Time to clinical relapse (defined as having at least moderately severe depression or anxiety symptoms, namely a score ≥15 on the PHQ-9 or ≥10 on the GAD-7) at the end of the 16-weeks follow-up period;, Exploratory end point: Time to clinical relapse (defined as having at least moderately severe depression or anxiety symptoms, namely a score ≥15 on the PHQ-9 or ≥10 on the GAD-7) at the end of the follow-up period (36 weeks from randomization);, Exploratory end point: Proportion of participants experiencing “withdrawal-associated relapse”, defined as having a score ≥15 on the PHQ-9 or ≥10 on the GAD-7 within 4 weeks after the participant experienced “clinically relevant” withdrawal symptoms during the tapering phase and the 16-weeks follow-up period;, Exploratory end point: PHQ-9 mean overall score at the end of 16-weeks follow-up period;, Exploratory end point: GAD-7 mean overall score at the end of 16-weeks follow-up period;, Exploratory end point: Proportion of participants with suicidal behaviours (including suicidal ideation, as reported by the participant, or according to a score ≥2 on the item 9 of the PHQ-9, suicide attempt, and deaths by suicide) at the end of 16-weeks follow-up period;, Exploraotry end point: Short Form 12 Health Survey (SF-12) (Gandek et al., 1998) mean score on the Mental Component Summary at the end of the 16-weeks follow-up period;, Exploratory end point: Social Adaptation Self-evaluation Scale (SASS) (Bosc et al., 1997) mean score at the end of the 16-weeks follow-up period;, Exploratory end point: Cost-effectiveness, based on an adapted version of the Client Sociodemographic and Service Receipt Inventory (CSSRI-EU) (Chisholm et al., 2000);

Source: https://euclinicaltrials.eu/ctis-public/view/2023-509377-23-00